EU clinical trial 2025-523748-11-00: Efficacy and tolerability of a simethicone-containing evacuating solution for colorectal cancer screening colonoscopy: a randomized parallel comparative trial. CLEAN+
Protocol code: CLEAN+
Sponsor: Fundacio De Recerca Clinic Barcelona-Institut D’Investigacions Biomediques August Pi I Sunyer (Laboratory/Research/Testing facility). Phase: Therapeutic use (Phase IV). Countries: Spain (ongoing, recruiting).
Therapeutic area(s): Diseases [C] - Digestive System Diseases [C06]; Analytical, Diagnostic and Therapeutic Techniques and Equipment [E] - Diagnosis [E01]
Gender: Female, Male. Age: 18-64 years, 65+ years. Enrolment: 818.
Status: Ongoing, recruiting. Start date (EU): 2026-05-18. Decision date: 2026-02-20. Results received: No. Last updated: 2026-02-20.

Condition(s): colorectal cancer early detection
Product: Clensia polvo para solución oral., CitraFleet Polvo para solución oral en sobre

Primary endpoint: Adenoma detection rate, defined as the proportion of patients with at least one adenoma in relation to the total number of subjects in each study group (Clensia® Group (Group A); Citrafleet® Group (Group B)).
Endpoint(s): Lesion detection rate, defined as the proportion of patients with at least one polyp in relation to the total number of subjects in each group., Adenomas per colonoscopy, defined as the mean number of adenomas detected by colonoscopy in the subjects in each group., The presence of foam and bubbles using the CEBuS (Colon Endoscopic Bubble Scale), in which each colonic segment (right colon, transverse colon, left colon) is scored from 0 to 2 (0=no or minimal number of bubbles; 1=moderate amount of bubbles affecting 5-50% of the circumference, affecting the vision of the mucosa and requiring additional time to wash; 2=abundant bubbles occupying >50% of the circumference, obscuring the mucosa and require ring additional time to washing)., The quality of colon cleansing using the Boston Scale, in which each colonic segment (right colon, transverse colon, and left colon) is scored from 0 to 3 (0=poor, 1=fair, 2=good, 3=excellent). A total score greater than or equal to 6 and greater than or equal to 2 in each segment will be considered adequate., Need for washing tools during colonoscopy. The amount of wash water used during the colonoscopy to complete the test satisfactorily is counted. Likewise, the volume of simethicone used will be counted if it is considered necessary., Cecal intubation rate. The colonoscopy will be considered complete if the cecum has been reached; otherwise, it will be considered incomplete., Cecal intubation time. Defined as the time elapsed between the introduction of the endoscope and reaching the cecal fundus., Endoscope removal time. Defined as the time elapsed between reaching the cecal fundus and completion of the endoscopy, including the time spent cleaning the colon and excluding endoscopic treatment of lesions., Proportion of patients who, after undergoing colonoscopy, require repeat colonoscopy due to poor preparation, defined as a total score of less than 6 or less than 2 in one of the three segments according to the Boston Scale., Adherence to the intake of the preparation assessed by compliance with the intake in three degrees: completely, more than 50%, less than 50% or not at all (Annex 3, Tolerability and satisfaction questionnaire)., Ease of taking the preparation assessed with a numerical assessment scale from 0=very difficult to 10=very easy (Annex 3, Tolerability and satisfaction questionnaire)., Palatability of the preparation assessed with a numerical assessment scale from 0=very bad to 10=excellent (Annex 3, Tolerability and satisfaction questionnaire)., Willingness to repeat the intake of the preparation assessed as yes or no (Annex 3, Tolerability and satisfaction questionnaire)., Overall satisfaction with the intake of the preparation assessed with a numerical rating scale from 0=very bad to 10=very good (Annex 3, Tolerability and satisfaction questionnaire)., Endoscopist's satisfaction with the cleaning of faecal remains and bubbles, assessed with a numerical assessment scale from 0 = very dissatisfied to 10 = very satisfied (Annex 4, Data collection form)., Rate of adverse events including symptoms such as nausea, vomiting, abdominal pain, abdominal bloating, headache, chills, dizziness and dry mouth, which will be assessed in the Tolerability and Satisfaction Questionnaire (Annex 3, Tolerability and Satisfaction Questionnaire).

Source: https://euclinicaltrials.eu/ctis-public/view/2025-523748-11-00